EU clinical trial 2024-517807-35-00: Randomised, double-blind, placebo-controlled, active-treatment clinical trial to assess the analgesic efficacy and safety of an oral combination of ibuprofen (arginine) -tramadol HCl administered to patients with moderate to severe pain after undergoing dental surgery.
Protocol code: FMLD-IOTRA2-47_FIII
Sponsor: Farmalider S.A. (Pharmaceutical company). Phase: Therapeutic confirmatory (Phase III). Countries: Spain (ended).
Therapeutic area(s): Not possible to specify
Gender: Female, Male. Age: 18-64 years, 65+ years. Enrolment: 346.
Status: Ended. Start date (EU): 2022-01-10. End date (EU): 2025-01-22. Decision date: 2024-10-30. Results received: No. Last updated: 2024-10-30.

Condition(s): Moderate to severe somatic pain.
Product: Espididol 400 mg granulado para solución oral sabor menta, Adolonta 100 mg/ml solución oral, PL 1 Granules for oral solution, Ibuprofen (arginine)/Tramadol HCl 400/37.5 mg granules for oral solution, PL 2 Oral solution

Primary endpoint: Sum of the Pain Intensity Differences from the start of administration until after 12 hours (SPID0-12h), measured through the Visual Analogue Scale (VAS).
Endpoint(s): Pain intensity (PI) and pain intensity difference (PID) in scheduled assessment times up to 48 hours from the start of administration of the study medication., Area Under the Curve of pain intensity differences during the first 12 hours of study medication administration., Sum of the pain intensity differences regarding baseline, at 6 hours (SPID0-6h) from the start of the administration of the study medication., Patient responder rate, defined as the percentage of patients with a SPID(0-12h) ≥ δs, Time to first pain relief (Pain intensity ↓33%)., Proportion of patients using rescue medication., Total use of the different standardised levels of rescue medication from the start of treatment up to 12 and up to 48 hours later (measured in number of rescues required from each level)., Time to the first rescue administration from the start of administration of the study medication., Vital signs (body temperature, heart rate and blood pressure) and general physical examination., Laboratory abnormalities., Adverse events.

Source: https://euclinicaltrials.eu/ctis-public/view/2024-517807-35-00